EU clinical trial 2024-519757-11-00: PREDONATION KIDNEY RESERVE: IMPACT IN THE EVOLUTION OF DONOR AND RECIPIENT RENAL FUNCTION IN A RENAL TRANSPLANTATION PROGRAMME OF LIVING DONOR
Protocol code: RR-DVIVO
Sponsor: University Hospital Of Canary Islands (Hospital/Clinic/Other health care facility). Phase: Therapeutic confirmatory (Phase III). Countries: Spain (authorised, recruitment pending).
Therapeutic area(s): Analytical, Diagnostic and Therapeutic Techniques and Equipment [E] - Diagnosis [E01]; Not possible to specify
Gender: Female, Male. Age: 18-64 years, 65+ years. Enrolment: 60.
Status: Authorised, recruitment pending. Decision date: 2024-12-09. Results received: No. Last updated: 2024-12-09.

Condition(s): Renal Transplantation, living donor
Product: Nephrotect solución para perfusión

Primary endpoint: Renal function evolution measured in the donor and recipient after renal transplantation. Renal function will be measured with a reference standard, plasma clearance of iohexol. Renal reserve will be assessed by intravenous infusion of an amino acid solution.

Source: https://euclinicaltrials.eu/ctis-public/view/2024-519757-11-00